EU clinical trial 2024-513399-17-00: A Phase III, Randomized, Open-Label, Controlled, Multi-Center, Global Study of First-Line MEDI4736 Monotherapy and MEDI4736 in Combination with Tremelimumab Versus Standard of Care Chemotherapy in Patients with Unresectable Stage IV Urothelial Cancer
Protocol code: DANUBE/D419BC00001
Sponsor: AstraZeneca AB (Pharmaceutical company). Phase: Therapeutic confirmatory (Phase III). Countries: Spain (ended), Greece (ended).
Therapeutic area(s): Diseases [C] - Neoplasms [C04]
Gender: Female, Male. Age: 18-64 years, 65+ years. Enrolment: 2.
Status: Ended. Start date (EU): 2015-12-11. End date (EU): 2025-04-15. Decision date: 2024-10-08. Results received: No. Last updated: 2025-06-20.
Decision dates by country: GR: 2025-01-09, ES: 2024-10-08

Condition(s): Adult patients (age ≥18 years) with histologically or cytologically documented transitional cell carcinoma (transitional cell and mixed transitional/non transitional cell histologies) of the urothelium (including renal pelvis, ureters, urinary bladder, and urethra), unresectable Stage IV, and who are chemotherapy-naïve.
Product: MYCOPHENOLATE MOFETIL, IMJUDO 20 mg/ml concentrate for solution for infusion., INFLIXIMAB, IMFINZI 50 mg/mL concentrate for solution for infusion.

Primary endpoint: overall survival (OS)
Endpoint(s): "1. Progression-free survival (PFS); 2. OS24; 3. Proportion of patients alive and progression-free at 12 months; 4. Objective response rate; 5. Duration of response; 6. Disease control rate; 7. Best objective response; 8. Time from randomization to second progression"

Source: https://euclinicaltrials.eu/ctis-public/view/2024-513399-17-00